EU clinical trial 2023-510162-27-00: A Randomized, Placebo-Controlled, Double-blind, Dose-Ranging, Multicenter, Phase IIb Clinical Trial to Investigate the Efficacy and Safety of allo-APZ2-CVU on Wound Healing of Therapy-Resistant Chronic Venous Ulcer (CVU)
Protocol code: allo-APZ2-CVU-IIb
Sponsor: Rheacell GmbH & Co. KG (Pharmaceutical company). Phase: Therapeutic exploratory (Phase II). Countries: Germany (ended).
Therapeutic area(s): Diseases [C] - Skin and Connective Tissue Diseases [C17]
Gender: Female, Male. Age: 18-64 years, 65+ years. Enrolment: 200.
Status: Ended. Start date (EU): 2021-08-18. End date (EU): 2025-11-25. Decision date: 2024-03-06. Results received: Yes. Last updated: 2025-08-21.

Condition(s): Chronic venous ulcers (CVU)
Product: allo-APZ2-CVU_2, allo-APZ2-CVU_1, allo-APZ2-CVU_3, Placebo

Primary endpoint: Complete wound closure at Week 18 already persisting for at least two weeks;, Adverse events;
Endpoint(s): Wound size change in percent at each post-baseline follow-up visit;, Time to complete wound closure;, Complete wound closures at each post-baseline follow-up visit;, Duration of wound closure;, Recurrence of the wound;, Quality of wound healing at each post-baseline follow-up visit;, Assessment of Quality of Life using the Wound-Quality of Life Questionnaire at V8, V11, V14;, Pain assessment as per numerical rating scale on each post-baseline efficacy follow-up visit;, Physical examination and vital signs at V14.

Source: https://euclinicaltrials.eu/ctis-public/view/2023-510162-27-00